EU clinical trial 2024-512963-30-00: PHASE II STUDY FOR PATIENTS WITH ADVANCED TRIPLE NEGATIVE OR METAPLASTIC HRPOSITIVE/HER2-NEGATIVE, PIK3CA/PTEN-ALTERED BREAST CANCER TREATED WITH ERIBULIN IN COMBINATION WITH MEN1611 -THE SABINA STUDY-
Protocol code: MEDOPP437
Sponsor: Medica Scientia Innovation Research S.L. (Pharmaceutical company). Phase: Therapeutic exploratory (Phase II). Countries: Spain (ongoing, recruitment ended).
Therapeutic area(s): Diseases [C] - Neoplasms [C04]
Gender: Female, Male. Age: 18-64 years, 65+ years. Enrolment: 14.
Status: Ongoing, recruitment ended. Start date (EU): 2023-05-24. Decision date: 2024-09-19. Results received: No. Last updated: 2026-05-04.

Condition(s): Locally advanced or unresectable PIK3CA and/or PTENaltered metaplastic HR-positive/HER2-negative breast cancer, Locally advanced or unresectable PIK3CA and/or PTENaltered metaplastic or non-metaplastic triple negative breast cancer.
Product: MEN1611 oral capsule 16 mg, HALAVEN 0.44 mg/ml solution for injection

Primary endpoint: CBR, defined as the percentage of patients who experience a complete response (CR), partial response (PR) or stable disease (SD) for at least 12 weeks after the start of treatment (MEN1611 in combination with eribulin), as determined locally by the Investigator per RECIST v1.1 criteria.
Endpoint(s): SECONDARY ENDPOINT: To assess the efficacy of MEN1611 in combination with eribulin as determined locally by the investigator as per RECIST v1.1 criteria by:, ORR defined as the proportion of patients with confirmed CR or PR., TTR defined as the time from the start of treatment to the first objective tumor response (tumor shrinkage of ≥ 30%)., DoR defined as the time from the first occurrence of a documented objective response to disease progression or death from any cause, whichever occurs first., PFS defined as the time from the first dose of Study drugs until objective tumor progression or death, whichever occurs first., OS defined as the time from the first dose of Study drugs until death from any cause., SECONDARY ENDPOINT: To evaluate the incidence of adverse events (AEs) as assessed by the investigator, with severity determined by NCI-CTCAE v.5.0 of MEN1611 in combination with eribulin.

Source: https://euclinicaltrials.eu/ctis-public/view/2024-512963-30-00